EU clinical trial 2024-516774-30-00: A study to assess the safety, tolerability and pharmacokinetics of tideglusib in subjects with hepatic impairment compared to healthy subjects.
Protocol code: AMO-02-MD-1-001
Sponsor: Amo Pharma Limited (Pharmaceutical company). Phase: Human Pharmacology (Phase I)- Other. Countries: Bulgaria (ended).
Therapeutic area(s): Diseases [C] - Nervous System Diseases [C10]; Diseases [C] - Musculoskeletal Diseases [C05]
Gender: Female, Male. Age: 18-64 years. Enrolment: 48.
Status: Ended. End date (EU): 2025-04-09. Decision date: 2024-10-09. Results received: No. Last updated: 2024-11-05.

Condition(s): Hepatic impairment, Healthy subjects

Source: https://euclinicaltrials.eu/ctis-public/view/2024-516774-30-00